EU clinical trial 2023-510337-29-00: Paxlovid long covid-19 prevention trial with recruitment in the community in Norway
Protocol code: PANORAMIC-Norway
Sponsor: Helse Bergen HF (Hospital/Clinic/Other health care facility). Phase: Therapeutic confirmatory (Phase III). Countries: Norway (ongoing, recruitment ended).
Therapeutic area(s): Diseases [C] - Virus Diseases [C02]
Gender: Female, Male. Age: 18-64 years. Enrolment: 2000.
Status: Ongoing, recruitment ended. Start date (EU): 2023-04-11. Decision date: 2024-06-24. Results received: No. Last updated: 2025-05-28.

Condition(s): Virus Diseases
Product: RITONAVIR, NIRMATRELVIR, Placebo: Round, white tablet with breakmarks on one side, no imprints 8 x 8 mm; Maydis amylum 10%, Cellulosum microcrist. 89%, Magnesii stearas 0,5% and Silica colloid. anhydr. 0,5%

Primary endpoint: Continued symptoms of acute COVID-19 and new symptoms according to long-COVID illness.
Endpoint(s): A cause, non-elective hospitalisation and/or death, within 28 days of randomisation., Participant reported symptoms daily for 7 days, weekly for 28 days and at 3 and 6 months., Contacts with health services reported by paticipants and/or captured by review for health registries., New infections in the household reported by the participants., Evaluation of overall safety of drugs by the monitoring of adverse events (AEs as defined in the ISAs)., Well-being, symptoms and health care utilisation., Resource use and cost data.

Source: https://euclinicaltrials.eu/ctis-public/view/2023-510337-29-00